EU clinical trial 2024-515514-40-00: Prospective, randomized, neoadjuvant phase II study with combination immuno-oncology in primary clear cell renal cell cancer at risk for recurrence or distant metastases (NESCIO-trial; M21NSC; CA209-6DJ)
Protocol code: CA209-6DJ
Sponsor: Het Nederlands Kanker Instituut-Antoni van Leeuwenhoek Ziekenhuis Stichting (Hospital/Clinic/Other health care facility). Phase: Therapeutic exploratory (Phase II). Countries: Netherlands (ongoing, recruitment ended).
Therapeutic area(s): Diseases [C] - Male Urogenital Diseases [C12]; Diseases [C] - Female Urogenital Diseases and Pregnancy Complications [C13]
Gender: Female, Male. Age: 18-64 years, 65+ years. Enrolment: 69.
Status: Ongoing, recruitment ended. Start date (EU): 2022-01-05. Decision date: 2024-08-22. Results received: No. Last updated: 2024-08-22.

Condition(s): Resectable intermediate to high-risk clear cell RCC (according to RECIST 1.1) that can be biopsied, no history of distant metastases, naïve for CTLA-4/PD-1/PD-L1/LAG-3 directed immunotherapy, and more than 18 years old
Product: RELATLIMAB, YERVOY 5 mg/ml concentrate for solution for infusion, OPDIVO 10 mg/mL concentrate for solution for infusion.

Primary endpoint: Pathologic response rate, defined as the proportion of patients demonstrating a complete pathologic or partial pathologic response, according to central revision (pathology of NKI)
Endpoint(s): Safety, as measured by the frequency of immune-related adverse events leading to postponing of surgery for > 2 weeks, Objective response rate, defined as the proportion of patients demonstrating a complete or partial response according to RECIST 1.1, at week 6, Recurrence Free Survival (RFS), defined as the time from randomization to recurrence or death from any cause, whichever occurs first. Subjects last known to be alive, who have not experienced recurrence, will be censored, Event-free survival (EFS), defined as the time from randomization to recurrence, distant metastasis, or death from any cause, whichever occurs first. Subjects who are event-free at the end of follow-up will be censored, Rate of distant metastases, defined as the proportion of patients starting treatment who experience distant metastases during follow-up, Rate of local recurrences, defined as the proportion of patients starting treatment who experience a local recurrence during follow-up, Surgical morbidity following neoadjuvant immunotherapy (according Clavien Dindo classification)

Source: https://euclinicaltrials.eu/ctis-public/view/2024-515514-40-00